EU clinical trial 2023-510417-25-01: CRISPR-TIL for metastatic melanoma
Protocol code: MM2318
Sponsor: Herlev Hospital (Hospital/Clinic/Other health care facility). Phase: Human Pharmacology (Phase I)- First administration to humans. Countries: Denmark (ongoing, recruiting).
Therapeutic area(s): Diseases [C] - Neoplasms [C04]
Gender: Female, Male. Age: 18-64 years, 65+ years. Enrolment: 10.
Status: Ongoing, recruiting. Start date (EU): 2024-12-06. Decision date: 2024-09-16. Results received: No. Last updated: 2024-09-16.

Condition(s): Advanced or metastatic melanoma

Source: https://euclinicaltrials.eu/ctis-public/view/2023-510417-25-01